EU clinical trial 2023-505246-26-00: Randomized, Double-blind, Placebo-controlled Phase 3 Study of JNJ-56021927 in Subjects with High-risk, Localized or Locally Advanced Prostate Cancer Receiving Treatment with Primary Radiation Therapy
Protocol code: 56021927PCR3003
Sponsor: Janssen - Cilag International (Pharmaceutical company). Phase: Therapeutic confirmatory (Phase III). Countries: Belgium (ongoing, recruitment ended), Czechia (ongoing, recruitment ended), Sweden (ongoing, recruitment ended), Romania (ongoing, recruitment ended), Spain (ongoing, recruitment ended), Germany (ongoing, recruitment ended), France (ongoing, recruitment ended), Italy (ongoing, recruitment ended), Poland (ongoing, recruitment ended).
Therapeutic area(s): Diseases [C] - Neoplasms [C04]
Gender: Male. Age: 18-64 years, 65+ years. Enrolment: 635.
Status: Ongoing, recruitment ended. Start date (EU): 2016-01-27. Decision date: 2023-10-09. Results received: No. Last updated: 2026-07-13.
Decision dates by country: DE: 2023-10-11, ES: 2023-10-11, SE: 2023-10-09, RO: 2023-10-11, PL: 2023-11-10, BE: 2023-10-10, FR: 2023-10-12, CZ: 2023-10-19, IT: 2023-10-20

Condition(s): High- or very-high risk, localized or locally advanced prostate cancer
Product: Bicalutamid PUREN 50 mg Filmtabletten, Apalutamide placebo, Bicalutamide placebo, JNJ-56021927

Primary endpoint: MFS is defined as the time from randomization to the date of the first occurrence of radiographic bone or soft tissue distant metastasis based on conventional imaging assesed by BICR, histopathologic diagnosis of distant metastasis, or death from any cause, whichever occurs first.

Source: https://euclinicaltrials.eu/ctis-public/view/2023-505246-26-00